EU clinical trial 2024-517450-95-00: A Phase 3, Single-Arm, Multiple-Dose, Pharmacokinetic Comparability Trial Between TAK-881 and HYQVIA in Adults With Chronic Inflammatory Demyelinating Polyradiculoneuropathy
Protocol code: TAK-881-3003
Sponsor: Takeda Development Center Americas Inc. (Pharmaceutical company). Phase: Therapeutic confirmatory (Phase III). Countries: Denmark (ongoing, recruiting), Czechia (ended), Sweden (authorised, recruiting), Poland (ongoing, recruiting), Italy (ongoing, recruiting), Germany (ongoing, recruiting), Greece (ongoing, recruiting), Spain (authorised, recruitment pending).
Therapeutic area(s): Diseases [C] - Immune System Diseases [C20]
Gender: Female, Male. Age: 18-64 years, 65+ years. Enrolment: 46.
Start date (EU): 2025-06-23. Decision date: 2025-06-02. Results received: No. Last updated: 2026-08-04.
Decision dates by country: DK: 2025-06-02, PL: 2025-06-08, GR: 2025-09-09, ES: 2025-09-15, CZ: 2025-06-03, DE: 2025-06-06, IT: 2025-07-29, SE: 2025-06-03

Condition(s): Chronic inflammatory demyelinating polyradiculoneuropathy (CIDP)
Product: HyQvia 100 mg/mL solution for infusion for subcutaneous use, TAK-881, HyQvia 100 mg/mL solution for infusion for subcutaneous use

Primary endpoint: 01. Baseline-uncorrected area under the curve during the dosing interval at steady-state (AUC0-τ,ss) based on total IgG levels.

Source: https://euclinicaltrials.eu/ctis-public/view/2024-517450-95-00